EU clinical trial 2023-508664-30-00: Efficacy and tolerance of nicotinamide supplementation during acute kidney injury: a prospective randomized double-blind trial
Sponsor: Assistance Publique Hopitaux De Marseille (Hospital/Clinic/Other health care facility). Phase: Therapeutic confirmatory (Phase III). Countries: France (authorised, recruitment pending).
Therapeutic area(s): Not possible to specify
Gender: Female, Male. Age: 18-64 years, 65+ years. Enrolment: 306.
Status: Authorised, recruitment pending. Decision date: 2025-05-28. Results received: No. Last updated: 2025-05-28.

Condition(s): Acute kidney injury
Product: NICOTINAMIDE, cellulose microcristalline

Primary endpoint: rate of complete renal recovery (success) assessed at day + 21 post-randomization. The complete renal recovery, (success) will be defined from the estimated glomerular filtration rate (eGFR): - if baseline eGFR is unknown; an eGFR >60ml/min (at day+21 according to the mention above) - if baseline eGFR is available; by the return to baseline eGFR +/- 3.

Source: https://euclinicaltrials.eu/ctis-public/view/2023-508664-30-00